EU clinical trial 2024-520299-86-00: Prednisone treatment in acute interstitial nephritis - a randomized prospective trial (PRAISE)
Protocol code: FHM-1-2017
Sponsor: Region Midtjylland (Hospital/Clinic/Other health care facility). Phase: Therapeutic use (Phase IV). Countries: Denmark (ongoing, recruiting).
Therapeutic area(s): Phenomena and Processes [G] - Immune System Phenomena [G13]; Diseases [C] - Immune System Diseases [C20]; Diseases [C] - Pathological Conditions, Signs and Symptoms [C23]
Gender: Female, Male. Age: 18-64 years, 65+ years. Enrolment: 110.
Status: Ongoing, recruiting. Start date (EU): 2025-01-22. Decision date: 2025-01-13. Results received: No. Last updated: 2025-10-10.

Condition(s): Acute interstitial nephritis
Product: Prednisolon "DAK", tabletter, Prednisolon "DAK", tabletter

Primary endpoint: eGFR at 3 months
Endpoint(s): Kidney function (eGFR) at 12 months, CKD stage, Number og patients in dialysis, Effekt of treatment-delay on outcome, Urinary biomarkers, Questionaire: SF36 score, The predictive value of histopathological evaluation, Safety endpoints: P-glukose, Infections, Submissions

Source: https://euclinicaltrials.eu/ctis-public/view/2024-520299-86-00